EU clinical trial 2025-521522-15-00: Standardized Dermatophagoides mix (D. pteronyssinus + D. farinae) in TBU/ml in liquid formulation for sublingual immunotherapy: Phase II, randomized dose determination clinical trial.
Protocol code: APISLIT-DD-D-2025-01
Sponsor: Asac Pharmaceutical Inmunology S.A., Advanced Outcomes Research S.L. (Pharmaceutical company). Phase: Therapeutic exploratory (Phase II). Countries: Spain (ongoing, recruiting).
Therapeutic area(s): Diseases [C] - Immune System Diseases [C20]
Gender: Female, Male. Age: 0-17 years, 18-64 years. Enrolment: 120.
Status: Ongoing, recruiting. Start date (EU): 2025-11-05. Decision date: 2025-09-17. Results received: No. Last updated: 2026-06-19.
Decision dates by country: ES: 2025-10-06

Condition(s): Allergic rhinitis/rhinoconjunctivitis caused by dust mite allergy
Product: Vacuna Dermatophagoides mezcla 6000 TBU/ml, Placebo, Test de provocación nasal, Vacuna Dermatophagoides mezcla 1000 TBU/ml, Vacuna Dermatophagoides mezcla 3000 TBU/ml

Primary endpoint: The individual response of each recruited subject to the nasal provocation test (NPT). To objectively assess the response, the change in Nasal Inspiratory Peak Flow (NIPF) will be measured using a rhinomanometer provided by the sponsor, and the response will be considered positive if the NIPF decreases by ≥ 40%. In addition, a clinical assessment will be performed based on the total sum of symptom scores on a 13-point scale.
Endpoint(s): Assessment of rescue medication use throughout the study in relation to the investigational product/placebo., Evaluation of adverse reactions occurring during the patient follow-up period specified in the study., Analytical determinations of serum markers (specific IgE to Dermatophagoides pteronyssinus, Dermatophagoides farinae, Der p1 and Der p2; and IgG4 to Dermatophagoides) at baseline and at the end of the study., Assessment of the primary wheal resulting from skin prick tests with Dermatophagoides pteronyssinus and Dermatophagoides farinae at baseline and at the end of the study: the primary wheal will be calculated as the mean of the two diameters ([largest diameter + smallest diameter] / 2). Subsequently, the group mean will be calculated based on the results of each enrolled subject, to allow for comparative analysis between groups., Evaluation of all individual variables from the scoring scale used in the nasal provocation test.

Source: https://euclinicaltrials.eu/ctis-public/view/2025-521522-15-00